EU clinical trial 2024-514399-42-00: MATVAC-1 : EVALUATION OF UCPVAX VACCINE +/- PEMBROLIZUMAB COMBINED WITH STANDARD TREATMENT AS ADJUVANT THERAPY IN PATIENTS WITH UNMETHYLATED MGMT GLIOBLASTOMA
Sponsor: Centre Hospitalier Regional Universitaire (Hospital/Clinic/Other health care facility). Phase: Therapeutic exploratory (Phase II). Countries: France (authorised, recruitment pending).
Therapeutic area(s): Diseases [C] - Immune System Diseases [C20]; Diseases [C] - Nervous System Diseases [C10]
Gender: Female, Male. Age: 18-64 years, 65+ years. Enrolment: 98.
Status: Authorised, recruitment pending. Decision date: 2025-11-12. Results received: No. Last updated: 2025-11-12.

Condition(s): Glioblastoma
Product: PEMBROLIZUMAB, UCPVax 1mg/2ml, TEMOZOLOMIDE

Primary endpoint: In each experimental arms, the primary endpoint for the efficacy is the rate of patients alive at 18 months post randomization
Endpoint(s): The rate of patients alive at 18 months post randomization, Overall survival (OS) defined as the time interval from randomization to the date of death from any cause. Alive patients will be censored at the last date known to be alive, either during study treatment period or during follow-up period, Progression free survival (PFS) according to RANO 2.0 criteria: defined as the time interval from the date of randomization to the date of first documented disease progression or death from any cause, whichever occurs first. Alive patients without progression will be censored at last radiological evaluation showing no progression during study treatment follow-up., Adverse events and routine lab abnormalities as characterized by type, frequency, severity (as graded by NCI CTCAE v 5.0, see Appendix 2), timing, seriousness and relationship to study treatments at each visit., Immunogenecity will be assess by ex vivo IFN-γ ELISpot in peripheral blood (Adotevi JCO 2023)., Health related Quality of life will be evaluated with EORTC-QLQC30 questionnaire and BN20 module at randomization and at 6 months.

Source: https://euclinicaltrials.eu/ctis-public/view/2024-514399-42-00